EU clinical trial 2023-508400-38-00: Evaluation of the addition of Everolimus to 177Lu-DOTATATE in the treatment of grades 2 and 3 refractory meningioma: a phase IIb clinical trial
Protocol code: 2021PI203
Sponsor: CHRU De Nancy (Hospital/Clinic/Other health care facility). Phase: Therapeutic exploratory (Phase II). Countries: France (ongoing, recruiting).
Therapeutic area(s): Diseases [C] - Nervous System Diseases [C10]
Gender: Female, Male. Age: 18-64 years, 65+ years. Enrolment: 28.
Status: Ongoing, recruiting. Start date (EU): 2024-11-29. Decision date: 2024-04-22. Results received: No. Last updated: 2026-02-19.

Condition(s): meningioma
Product: Everolimus beta 2,5 mg Tabletten, Lutathera 370 MBq/mL solution for infusion, Everolimus beta 5 mg Tabletten, Everolimus PUREN 2,5 mg Tabletten, Everolimus PUREN 5 mg Tabletten

Primary endpoint: PFS-6 from the start of treatment according to the RANO criteria
Endpoint(s): 1) OS-12. Overall Survival, defined as the time from the date of first administration of Luthatera to the date of death from any cause., 2) Tumor growth rate, defined as the product of the two largest diameters of the target lesion from the MRI at M3 or M6 compared to the diameters of the lesion at baseline., 3) PFS-6. Dose delivered to the tumor (dosimetry) will be calculated on at least 2 skull scans with 177Lu-DOTATATE SPECT-CT (D1 and D7), after the first cycle of 177Lu-DOTATATE., 4) OS-12. Dose delivered to the tumor (dosimetry) will be calculated on at least 2 skull scans with 177Lu-DOTATATE SPECT-CT (D1 and D7), after the first cycle of 177Lu-DOTATATE., 5) Number and types of grade 1, 2, 3 or 4 adverse events according to the CTCAE (Common Terminology Criteria for Adverse Events) classification per patient, from the start of treatment until 180 days after the end of the last treatment cycle., 6) HRQoL, assessed using the EORTC QLQ-C30 questionnaire at inclusion (V1) and 6 months after Luthatera first administration (V8)

Source: https://euclinicaltrials.eu/ctis-public/view/2023-508400-38-00